EU clinical trial 2023-509851-15-00: A PRECISION MEDICINE TRIAL LEVERAGING BLOOD-BASED TUMOR GENOMICS TO OPTIMIZE TREATMENT IN OPERABLE STAGE III AND HIGH-RISK STAGE II COLON CANCER PATIENTS
Protocol code: IFOM-CPT0092022PO008
Sponsor: Ifom Istituto Fondazione Di Oncologia Molecolare Ets In Breve Ifom Ets (Laboratory/Research/Testing facility). Phase: Therapeutic confirmatory (Phase III). Countries: Spain (ongoing, recruiting), Italy (ongoing, recruiting), Germany (ongoing, recruiting).
Therapeutic area(s): Diseases [C] - Neoplasms [C04]
Gender: Female, Male. Age: 18-64 years, 65+ years. Enrolment: 740.
Status: Ongoing, recruiting. Start date (EU): 2024-10-22. Decision date: 2024-05-29. Results received: No. Last updated: 2025-11-07.
Decision dates by country: DE: 2024-11-18, ES: 2024-05-29, IT: 2024-05-31

Condition(s): Colon cancer
Product: PANITUMUMAB, CAPECITABINE, CAPECITABINE, DISODIUM LEVOFOLINATE, CALCIUM LEVOFOLINATE, FLUOROURACIL, NIVOLUMAB, TEMOZOLOMIDE, FOLINIC ACID, TRASTUZUMAB, TEMOZOLOMIDE, PERTUZUMAB, TEMOZOLOMIDE, OXALIPLATIN, IPILIMUMAB, IRINOTECAN

Primary endpoint: 2-year RFS in patients with a post-surgery ctDNA positivity randomized 1:1 to receive either a conventional adjuvant chemotherapy or a personalized targeted treatment strategy.
Endpoint(s): 2-year RFS in patients with a post-surgery ctDNA negativity randomized 1:1 to receive either a physician-choice strategy or an intensive follow-up strategy., 3 and 5-year RFS and OS in patients with a post-surgery ctDNA positivity (Trial-1) and ctDNA negativity (Trial-2) randomized either in the conventional or experimental Trials., Safety and tolerability according to Clinical Trials Criteria for Adverse Events (CTCAE) version 5.0 (Trial-1, Trial-2 and whole study population)., Number of false negative cases after three consecutive negative LBs, defined as cases that experience radiological relapse within 2 years., Number of patients experiencing ctDNA seroconversion (i.e., ctDNA+ that become ctDNA-) after any therapy regimen remaining disease free at 2 and 3 years, Assessment of FACT-C and EQ-5D-5L questionnaires in the whole study population.

Source: https://euclinicaltrials.eu/ctis-public/view/2023-509851-15-00